EU clinical trial 2024-519786-22-01: A Phase Ib/II Open-Label, Multicentre Platform Study Evaluating Novel Combinations in Participants with Advanced or Metastatic Non-Small Cell Lung Cancer (ALTAIR)
Protocol code: D702KC00001
Sponsor: AstraZeneca AB (Pharmaceutical company). Phase: Phase I and Phase II (Integrated)- Other. Countries: Germany (authorised, recruitment pending), Spain (authorised, recruitment pending), France (authorised, recruitment pending), Poland (authorised, recruitment pending), Belgium (authorised, recruitment pending), Netherlands (authorised, recruitment pending), Italy (authorised, recruitment pending).
Therapeutic area(s): Diseases [C] - Neoplasms [C04]
Gender: Female, Male. Age: 18-64 years, 65+ years. Enrolment: 56.
Status: Authorised, recruitment pending. Decision date: 2026-03-30. Results received: No. Last updated: 2026-05-22.
Decision dates by country: BE: 2026-03-30, FR: 2026-03-31, ES: 2026-03-31, PL: 2026-04-03, DE: 2026-04-07, IT: 2026-04-01, NL: 2026-04-01

Condition(s): metastatic non-small cell lung cancer (NSCLC)
Product: Cyramza 10 mg/ml concentrate for solution for infusion, Cyramza 10 mg/ml concentrate for solution for infusion, Cyramza 10 mg/ml concentrate for solution for infusion, Rilvegostomig

Primary endpoint: Part A: Safety run-in. Safety and tolerability will be evaluated in terms of DLT (to determine the recommended dose), AEs/SAEs, imAEs, AEs leading to discontinuation, laboratory findings, ECGs, vital signs, and physical examinations.The estimates of interest are:-Incidence of AEs/SAEs, imAEs, and AEs leading to discontinuation -Incidence of DLTs-Mean changes from baseline in laboratory parameters, vital signs, ECGs, and physical examination., Part B: Dose expansion Safety and tolerability will be evaluated in terms of AEs/SAEs, imAEs, AEs leading to discontinuation, laboratory findings, ECGs, vital signs, and physical examinations.The estimates of interest are:Incidence of AEs/SAEs, imAEs, and AEs leading to discontinuation.Mean changes from baseline in laboratory parameters, vital signs, ECGs, and physical examination., Part B: Dose expansion :Objective response is defined as BOR of confirmed CR or confirmed PR, as determined by the investigator at local site per RECIST1.1. The estimate of interest is • OR The analysis will include participants in the Response Evaluable Analysis Set. Participants will be analyzed according to their planned treatment and indication
Endpoint(s): Part A: Safety run-in • OR • DOR, TTR, DC • PFS and OS, Part B: Dose expansion :•DOR, TTR, DC (similar to Part A efficacy) •PFS (similar to Part A efficacy) •OS (similar to Part A efficacy), All parts of the study :Serum concentrations and derived PK parameters of novel agents, All parts of the study:Incidence of ADAs against novel agents in serum

Source: https://euclinicaltrials.eu/ctis-public/view/2024-519786-22-01